EU clinical trial 2025-522974-35-00: EFFICACY OF INFILTRATED MEPIVACAINE AS A LOCAL ANESTHETIC PRIOR TO ARTERIAL PUNCTURE: A RANDOMIZED CONTROLLED CLINICAL TRIAL
Protocol code: MEPI
Sponsor: University Of The Basque Country (Educational Institution). Phase: Therapeutic use (Phase IV). Countries: Spain (authorised, recruitment pending).
Therapeutic area(s): Diseases [C] - Respiratory Tract Diseases [C08]
Gender: Female, Male. Age: 18-64 years, 65+ years. Enrolment: 108.
Status: Authorised, recruitment pending. Decision date: 2026-01-28. Results received: No. Last updated: 2026-01-28.

Condition(s): Respiratory disease. Prescripcion o indicación de gasometría.
Product: Mepivacaina B.Braun 10 mg/ml solución inyectable, Suero Fisiológico Braun 0,9% disolvente para uso parenteral Cloruro de sodio

Primary endpoint: To evaluate the efficacy of infiltrated mepivacaine versus placebo and nothing at all in reducing pain caused by an arterial puncture during blood gas analysis in patients attending the Pulmonology Outpatient Clinic at Galdakao-Usansolo Hospital.

Source: https://euclinicaltrials.eu/ctis-public/view/2025-522974-35-00